EU clinical trial 2024-519964-42-00: An Open-Label, Phase 2 Study to Evaluate Safety, Tolerability and Preliminary Activity of the CTPS1 Inhibitor STP938 in Adult Subjects with High Risk Essential Thrombocythaemia who are Resistant to or Intolerant of Hydroxycarbamide Therapy. The VECTRA Study
Protocol code: STP938-301
Sponsor: Step Pharma (Pharmaceutical company). Phase: Therapeutic exploratory (Phase II). Countries: France (ongoing, recruiting).
Therapeutic area(s): Diseases [C] - Hemic and Lymphatic Diseases [C15]
Gender: Female, Male. Age: 18-64 years, 65+ years. Enrolment: 30.
Status: Ongoing, recruiting. Start date (EU): 2025-07-02. Decision date: 2025-05-13. Results received: No. Last updated: 2026-06-18.

Condition(s): Thrombocythaemia

Source: https://euclinicaltrials.eu/ctis-public/view/2024-519964-42-00